EU clinical trial 2024-510630-40-00: Randomized Autologous heMatopoietic stem cell transplantation versus alemtuzumab, cladribine or ocrelizumab for patients with relapsing remitting Multiple Sclerosis (RAM-MS)
Sponsor: Helse Bergen HF (Hospital/Clinic/Other health care facility). Phase: Therapeutic confirmatory (Phase III). Countries: Netherlands (ongoing, recruitment ended), Norway (ongoing, recruitment ended), Sweden (ended), Denmark (ongoing, recruitment ended).
Therapeutic area(s): Diseases [C] - Immune System Diseases [C20]; Diseases [C] - Nervous System Diseases [C10]
Gender: Female, Male. Age: 18-64 years. Enrolment: 100.
Start date (EU): 2018-02-12. Decision date: 2024-06-06. Results received: No. Last updated: 2024-06-12.
Decision dates by country: DK: 2024-06-06, SE: 2024-06-07, NL: 2024-06-06, NO: 2024-06-12

Condition(s): Multiple sclerosis
Product: MAVENCLAD 10 mg tablets, Thymoglobuline 25 mg powder for solution for infusion, Sendoxan 1000 mg pulver til injeksjonsvæske, oppløsning, Ocrevus 300 mg concentrate for solution for infusion, LEMTRADA 12 mg concentrate for solution for infusion

Primary endpoint: The primary efficacy endpoint of this prospective, randomized study is to determine differences between patients in the 2 treatment arms according to the following criteria: Proportion of patients with no evidence of disease activity after a 2 year (96 week) and 5 year (240 week) period. NEDA is the absence of a protocol defined disease activity event.
Endpoint(s): Proportion of patients with no evidence of disease activity, including atrophy (NEDA 4), as per protocol defined disease activity events (as defined in section 2.2) plus atrophy (measured yearly atrophy above threshold of 0, 4 %) during a 2 year (96 week) and a 5 year (240 week) period4, with re-baseline for brain athrophy at 48 weeks., Time to first protocol-defined disease activity event as defined in section 2.2, Change in EQ-5D-5L from baseline to Week 96, and from baseline to Week 240, Change in Fatigue Severity Scale (FSS) from baseline to Week 96, and from baseline to Week 240, Change in Multiple Sclerosis Impact Scale (MSIS)-29 from baseline to Week 96, and from baseline to Week 240, Change in EDSS from baseline (Visit 4.1) to Week 96 , and from baseline to Week 240, The proportion of patients who, at Week 96 and at Week 240, have protocol-defined Confirmed Disability Improvement (CDI) , confirmed stable EDSS or Confirmed Disability Progression (CDP) compared to baseline, Annualized rate of protocol-defined relapses during 96 weeks and 240 weeks from start of study treatment, Time to onset of first protocol-defined relapse from start of study treatment, Change in MRI T2-weighted hyperintense lesion volume from baseline to Weeks 48 and 96, and from baseline to Week 144, 192 and 240, Change in MRI T1-weighted hypointense lesion volume from baseline to Weeks 48 and 96, and from baseline to Week 144, 192 and 240, Change in brain volume from re-baseline at week 48, to week 96, from re-baseline at week 48, to Week 144, 192 and 240, Time to detection of a new MRI T2 lesion, Total number of MRI T1-weighted Gd-enhanced lesions at weeks 24, 48, 96, 144, 192 and 240, Proportion of patients free from T1 Gd-enhancing lesions at weeks 24, 48, 96, 144, 192 and 240, Change in Nine-hole-peg test (9-HPT) score from baseline to week 48, 96 and 240, Change in Timed 25 foot walk (T25FW) score from baseline to week 48, 96 and 240, Change in The Brief International Cognitive Assessment for Multiple Sclerosis (BICAMS) score from baseline to week 96 and 240, Overall survival rate at week 96 and 240, Work productivity and activity impairment at week 96, 144, 192 and 240

Source: https://euclinicaltrials.eu/ctis-public/view/2024-510630-40-00